EU clinical trial 2024-520387-34-00: A multicentre randomised study on percutaneous stellate ganglion block as first line treatment in patients with electrical storm: the STAR 2 study
Protocol code: STAR 2
Sponsor: Fondazione IRCCS Policlinico San Matteo (Hospital/Clinic/Other health care facility). Phase: Therapeutic use (Phase IV). Countries: Italy (not authorised).
Therapeutic area(s): Diseases [C] - Cardiovascular Diseases [C14]
Gender: Female, Male. Age: 18-64 years, 65+ years. Enrolment: 180.
Status: Not authorised. Decision date: 2025-11-25. Results received: No. Last updated: 2025-11-25.

Condition(s): electrical storm
Product: Amiodarone Hikma 50 mg/ml soluzione iniettabile, BUPISEN 5 mg/ml soluzione iniettabile, Lidocaina Kabi 20 mg/ml soluzione iniettabile

Primary endpoint: proportion of patients with complete suppression of treated VA (with ATP, internal DC shock or external DC shock) during the first three hours after treatment

Source: https://euclinicaltrials.eu/ctis-public/view/2024-520387-34-00